EU clinical trial 2022-501966-23-00: Adjuvant Therapy with Pembrolizumab versus Placebo in Resected Highrisk Stage II Melanoma: A Randomized, Double-blind Phase 3 Study (KEYNOTE 716)
Protocol code: MK-3475-716
Sponsor: Merck Sharp & Dohme LLC (Pharmaceutical company). Phase: Therapeutic confirmatory (Phase III). Countries: Italy (ongoing, recruitment ended), Spain (ongoing, recruitment ended), Germany (ongoing, recruitment ended), Belgium (ongoing, recruitment ended), France (ongoing, recruitment ended), Poland (ongoing, recruitment ended).
Therapeutic area(s): Diseases [C] - Neoplasms [C04]
Gender: Female, Male. Age: 0-17 years, 18-64 years, 65+ years. Enrolment: 530.
Status: Ongoing, recruitment ended. Start date (EU): 2018-09-11. Decision date: 2023-09-25. Results received: No. Last updated: 2026-04-30.
Decision dates by country: PL: 2023-11-03, IT: 2023-09-26, ES: 2023-09-29, FR: 2023-09-28, DE: 2023-09-28, BE: 2023-09-25

Condition(s): Resected High-Risk Stage II Melanoma
Product: KEYTRUDA 25 mg/mL concentrate for solution for infusion, Placebo to Keytruda - Normal saline

Primary endpoint: Recurrence-free Survival (RFS)
Endpoint(s): Distant Metastasis-free Survival (DMFS), Overall Survival (OS), Number of Participants Who Experienced at Least One Adverse Event (AE), Number of Participants Who Discontinued Study Treatment Due to an AE

Source: https://euclinicaltrials.eu/ctis-public/view/2022-501966-23-00